EU clinical trial 2023-504920-25-00: A Phase 3, Randomized, Double-Blind Study to Evaluate the Efficacy and Safety of MK-0616 Compared With Ezetimibe or Bempedoic Acid or Ezetimibe and Bempedoic Acid in Adults With Hypercholesterolemia
Protocol code: MK-0616-018
Sponsor: Merck Sharp & Dohme LLC (Pharmaceutical company). Phase: Therapeutic confirmatory (Phase III). Countries: Spain (ended), France (ended).
Therapeutic area(s): Diseases [C] - Cardiovascular Diseases [C14]
Gender: Female, Male. Age: 18-64 years, 65+ years. Enrolment: 70.
Status: Ended. Start date (EU): 2024-08-23. End date (EU): 2025-02-27. End date: 2025-03-28. Decision date: 2024-08-09. Results received: Yes. Last updated: 2025-02-20.
Decision dates by country: ES: 2024-08-09, FR: 2024-08-14

Condition(s): Hypercholesterolemia
Product: Placebo for MK-0616, Placebo for Ezetimibe, EZETIMIBE, BEMPEDOIC ACID, MK-0616, Placebo for Bempedoic Acid

Primary endpoint: Mean percent change from baseline in LDL-C at Day 56
Endpoint(s): Mean percent change from baseline in ApoB at Day 56, Mean percent change from baseline in non-HDL-C at Day 56, Mean percent change from baseline in Lp(a) at Day 56, Percentage of participants who at Day 56 have an LDL-C <70 mg/dL and ≥50% reduction from baseline, Percentage of participants who at Day 56 have an LDL-C<55 mg/dL and ≥50% reduction from baseline, Number of participants with ≥1 adverse event (AE), Number of participants discontinuing from study therapy due to AE

Source: https://euclinicaltrials.eu/ctis-public/view/2023-504920-25-00